EU clinical trial 2023-506791-27-00: A Prospective, Open-label, Platform Study for Long-term Follow-up of Participants Using Study Intervention in Pulmonary Hypertension Parent Studies
Protocol code: NOPRODPAPUH3001
Sponsor: Actelion Pharmaceuticals Ltd. (Pharmaceutical company). Phase: Therapeutic confirmatory (Phase III). Countries: Bulgaria (ongoing, recruiting), Poland (ongoing, recruiting), Hungary (ongoing, recruiting).
Therapeutic area(s): Diseases [C] - Respiratory Tract Diseases [C08]
Gender: Female, Male. Age: 0-17 years, 18-64 years, 65+ years. Enrolment: 18.
Status: Ongoing, recruiting. Start date (EU): 2022-04-22. Decision date: 2024-03-13. Results received: No. Last updated: 2026-05-12.
Decision dates by country: BG: 2024-03-13, HU: 2025-03-19, PL: 2024-03-15

Condition(s): pulmonary arterial hypertension
Product: JNJ-67896049, JNJ-67896049, Opsumit 10 mg film-coated tablets, JNJ-68150420, JNJ-67896049

Primary endpoint: Frequency of treatment-emergent adverse events (AEs), treatment-emergent AEs leading to discontinuation, serious adverse events (SAEs), and/or deaths from baseline until End-of-Study (EOS)

Source: https://euclinicaltrials.eu/ctis-public/view/2023-506791-27-00